EU clinical trial 2023-509428-16-00: A Phase 2/3, Open-Label Study to Evaluate the Pharmacokinetics, Safety, and Antiviral Activity of Bictegravir/Lenacapavir in Children and Adolescents With HIV-1
Protocol code: GS-US-621-6463
Sponsor: Gilead Sciences Inc. (Pharmaceutical company). Phase: Phase II and Phase III (Integrated). Countries: Italy (ongoing, recruiting), Spain (ongoing, recruiting).
Therapeutic area(s): Diseases [C] - Virus Diseases [C02]
Gender: Female, Male. Age: 0-17 years. Enrolment: 17.
Status: Ongoing, recruiting. Start date (EU): 2024-10-15. Decision date: 2024-09-23. Results received: No. Last updated: 2026-07-31.
Decision dates by country: ES: 2024-09-25, IT: 2024-09-23

Condition(s): HIV-1 Infection
Product: BICTEGRAVIR 75 MG/LENACAPAVIR 50 MG FDC TABLETS, Sunlenca 300 mg film-coated tablets

Primary endpoint: Steady-state PK parameters (Cmax, AUCtau, and Ctau) of BIC and LEN, Proportion of participants experiencing treatment-emergent AEs through Week 24, Proportion of participants experiencing treatment-emergent laboratory abnormalities through Week 24
Endpoint(s): Steady-state PK parameters (AUClast, Ctrough, Tmax, Tlast, t1/2, CL, Vz, and λz) for BIC and LEN, Proportion of participants experiencing treatment-emergent AEs through Week 48, Proportion of participants experiencing treatment-emergent laboratory abnormalities through Week 48, Proportion of participants with plasma HIV-1 RNA < 50 copies/mL and ≥ 50 copies/mL at Weeks 24 and 48 based on the US Food and Drug Administration (FDA)-defined snapshot algorithm, Change from baseline in CD4 cell counts and percentages at Weeks 24 and 48, Acceptability and palatability summary of LEN oral loading dose at Day 1 and Day 2 assessed by questionnaire, Acceptability and palatability summary of oral BIC/LEN oral FDC at Day 1, Week 4, Week 24, and Week 48 assessed by questionnaire

Source: https://euclinicaltrials.eu/ctis-public/view/2023-509428-16-00